EU clinical trial 2023-509497-30-00: TRUST : BINTRAFUSP ALFA AND DOXORUBICIN HYDROCHLORIDE IN TREATING PATIENTS WITH ADVANCED SARCOMA
Protocol code: IB 2020-05
Sponsor: Institut Bergonie (Hospital/Clinic/Other health care facility). Phase: Therapeutic exploratory (Phase II). Countries: France (ongoing, recruitment ended).
Therapeutic area(s): Diseases [C] - Neoplasms [C04]
Gender: Female, Male. Age: 18-64 years, 65+ years. Enrolment: 80.
Status: Ongoing, recruitment ended. Start date (EU): 2022-02-21. Decision date: 2024-10-25. Results received: No. Last updated: 2025-12-12.

Condition(s): Adult patients with locally advanced/unresectable and/or metastatic soft-tissue sarcomas.
Product: DOXORUBICINE ACCORD 2 mg/ml, solution pour perfusion, Bintrafusp alfa (anti-PD-L1/TGFβ Trap)

Primary endpoint: Efficacy will be assessed in terms of 6-month progression-free rate, as per the Response Evaluation Criteria in Solid Tumors (RECIST v1.1). This endpoint is a validated endpoint in STS (30). Non-progression is defined as complete or partial response (CR, PR) or stable disease (SD), as per RECIST v1.1. Disease status at 6 months will be centrally reviewed for all patients by an expert radiologist blinded to the treatment. Reviewed data will be used for the primary efficacy analysis.
Endpoint(s): Objective response is defined as complete response (CR) or partial response (PR) defined as per RECIST evaluation criteria v1.1. Claimed responses will have to be confirmed at least 4 weeks later to ensure responses identified are not the results of measurement errors., Duration of overall response is measured from the time measurement criteria are met for CR or PR (whichever status is recorded first) until the first date that recurrence or PD is objectively documented, taking as reference for PD the smallest measurements recorded since the treatment started., Best overall response under treatment is defined as the best response recorded from the start of the study treatment until the end of treatment taking into account any requirement for confirmation as per RECIST v1.1 criteria. It is determined once all the data for the patient is known., Progression-Free Survival (PFS) is defined as the time from randomization to the first occurrence of disease progression (defined as per RECIST V1.1) or death (of any cause), whichever occurs first. Median PFS and 1-year PFS will be reported., Overall Survival (OS) is defined as the time from randomization to death (of any cause). Median OS and 1-year OS will be reported., Immune response is defined following (iRECIST - Seymour et al. 2017). Analysis of Immune-related response will be based on blinded central radiological review data., Safety will be graded using the common toxicity criteria from the NCI CTC-AE v5.0.

Source: https://euclinicaltrials.eu/ctis-public/view/2023-509497-30-00